EU clinical trial 2023-505700-35-00: Modified osimertinib dosing, with or without cobicistat as a pharmacokinetic booster, to improve cost-effectiveness of advanced Non-Small Cell Lung Cancer treatment - OSIBOOST 2
Sponsor: University Hospital Maastricht (Hospital/Clinic/Other health care facility). Phase: Therapeutic exploratory (Phase II). Countries: Netherlands (ongoing, recruiting).
Therapeutic area(s): Diseases [C] - Respiratory Tract Diseases [C08]
Gender: Female, Male. Age: 18-64 years, 65+ years. Enrolment: 60.
Status: Ongoing, recruiting. Start date (EU): 2024-07-16. Decision date: 2024-01-25. Results received: No. Last updated: 2025-06-10.

Condition(s): Non-Small Cell Lung Cancer with an EGFR driver mutation.
Product: Tybost 150 mg film-coated tablets, TAGRISSO 80 mg film-coated tablets

Primary endpoint: OSIBOOST 2-A: The daily cumulative dose reduction accomplished in individual patients, while retaining osimertinib exposure (i.e. osimertinib trough (Cmin,SS) levels within the specified provisional therapeutic range (125 – 259 ng/mL)., OSIBOOST 2-B: CNS disease control rate (DCR) at 12 weeks.
Endpoint(s): Osimertinib and AZ5104 trough concentrations in plasma during steady state, Number of (Serious) Adverse Events and Suspected Unexpected Serious Adverse Reaction events during trial course and follow-up., OSIBOOST 2-A: Average osimertinib intake reduction over time., Progression-Free Survival (PFS) during osimertinib/cobicistat concomitant treatment., CYP3A genotype., OSIBOOST 2-B: Trough concentrations levels at steady state for osimertinib and AZ5104 in cerebrospinal fluid., OSIBOOST 2-B: ctDNA analysis of cerebrospinal fluid.

Source: https://euclinicaltrials.eu/ctis-public/view/2023-505700-35-00